EU clinical trial 2024-516207-17-00: PhagoDAIR I : A Pilot, Multicenter, Randomized, Non Comparative, Double-Blind Study of Phage Therapy in Patients with Hip or Knee Prosthetic Joint Infection due to Staphylococcus aureus Treated with DAIR and Antibiotic Therapy.
Sponsor: Phaxiam Therapeutics (Pharmaceutical company). Phase: Therapeutic exploratory (Phase II). Countries: France (ended).
Therapeutic area(s): Diseases [C] - Bacterial Infections and Mycoses [C01]
Gender: Female, Male. Age: 18-64 years, 65+ years. Enrolment: 29.
Status: Ended. Start date (EU): 2022-06-15. End date (EU): 2025-04-08. Decision date: 2024-08-12. Results received: No. Last updated: 2025-03-24.

Condition(s): knee or hip prosthetic joint infection (PJI) due to Staphylococcus aureus, with the indication of DAIR and Suppressive Antibiotics Therapy (SAT)
Product: PP1493, PP1815, CHLORURE DE SODIUM FRESENIUS 0,9 %, solution pour perfusion

Primary endpoint: Clinical control of infection defined by: no clinical signs of evolutive infection: no fever (defined by a temperature less than 38°C) due to prosthesis infection and no recurrence, neither recurrent, nor worsening pain, Peri articular Inflammatory and infectious Clinical signs will be collected : No local post surgical recurrence or worsening of local articular swelling / No unusual aspect of scar as erythema or abnormal flow or a fistula or inflammatory or local necrosis or no healing, No new surgical procedure requested and no Staphylococcus aureus detected
Endpoint(s): Safety parameters: adverse events, physical examination, biological tests as hematology and biochemistry during the whole study, Initial activity of phages: active bacteriophages (PP1493 and/or PP1815) in regard of the clinical outcome (infection control or relapse) of patients, Clinical control of the infection (as described in primary endpoint) for superinfected patients (other species isolated during the surgical procedure), In case of failure, aspiration of joint fluid at time of failure for microbiological test and identification of Staphylococcus aureus strain: antibiogram, Duration of hospitalization, Questionnaire EQ-5D-5L for quality of life at each visit (except D14±1 and D28±2), Evaluation of joint function with: - Knee: KOOS 12-Knee Survey - Hip: HOOS 12-Hip Survey, Clinical control of the infection (as described in primary endpoint), To check potential appearance of abnormal loosening (border with shifting of the prosthesis) or an abnormal periprosthetic border, In case of rescue treatment: clinical infection control after the first ultra guided injection, safety parameters, pharmacokinetics, bacteriological and immunological tests

Source: https://euclinicaltrials.eu/ctis-public/view/2024-516207-17-00